EU clinical trial 2024-517035-43-00: Budesonide as a treatment for low-grade duodenal inflammation in functional dyspepsia.
Sponsor: UZ Leuven (Hospital/Clinic/Other health care facility). Phase: Therapeutic use (Phase IV). Countries: Belgium (ongoing, recruiting).
Therapeutic area(s): Diseases [C] - Digestive System Diseases [C06]
Gender: Female, Male. Age: 18-64 years, 65+ years. Enrolment: 56.
Status: Ongoing, recruiting. Start date (EU): 2024-05-01. Decision date: 2024-10-25. Results received: No. Last updated: 2025-10-31.

Condition(s): Functional Dyspepsia
Product: Mannitol, 1mg, Oral use, Jorveza 1 mg orodispersible tablets

Primary endpoint: Duodenal eosinophils before treatment and after 8 weeks of treatment
Endpoint(s): Gastro-intestinal symptoms of patients, based on the Leuven Postprandial Distress Scale (LPDS) before treatment and after 8 weeks of treatment, Quality of life of patients before treatment and after 8 weeks of treatment, State of anxiety, depression and somatization before treatment and after 8 weeks of treatment, Mucosal permeability, including gene and protein expression of major tight-junction related molecules and cytokines before treatment and after 8 weeks of treatment, Gastric motility by assessing gastric emptying time, gastric sensitivity to distension and gastric accommodation reflex before treatment and after 8 weeks of treatment, The mucosa-associated microbiome before treatment and after 8 weeks of treatment

Source: https://euclinicaltrials.eu/ctis-public/view/2024-517035-43-00